EU clinical trial 2025-521858-42-00: An open-label, parallel, Phase 3, two-arm study to investigate the efficacy and safety of fitusiran prophylaxis in male participants aged 1 to less than 12 years with hemophilia A or B with or without inhibitory antibodies to Factors VIII or IX
Protocol code: EFC17905
Sponsor: Sanofi-Aventis Recherche & Developpement (Pharmaceutical company). Phase: Therapeutic confirmatory (Phase III). Countries: Belgium (authorised, recruitment pending), Italy (authorised, recruitment pending), Romania (authorised, recruitment pending), Germany (authorised, recruitment pending), Hungary (authorised, recruitment pending), Spain (ongoing, recruiting), Poland (authorised, recruitment pending).
Therapeutic area(s): Diseases [C] - Hemic and Lymphatic Diseases [C15]
Gender: Male. Age: 0-17 years. Enrolment: 26.
Start date (EU): 2026-03-16. Decision date: 2026-01-15. Results received: No. Last updated: 2026-07-13.
Decision dates by country: HU: 2026-01-16, IT: 2026-01-16, BE: 2026-01-15, DE: 2026-01-16, ES: 2026-01-16, PL: 2026-01-19, RO: 2026-01-19

Condition(s): Hemophilia
Product: SAR439774, SAR439774

Primary endpoint: Annualized treated bleeding rate (ABR) in the fitusiran primary efficacy period and in the SOC period.
Endpoint(s): Annualized spontaneous bleeding rate (AsBR) in the fitusiran primary efficacy period and in the SOC period., Annualized joint bleeding rate (AjBR) in the fitusiran primary efficacy period and in the SOC period, ABR in the fitusiran treatment period (160 weeks) for fitusiran-naïve participants., ABR in the fitusiran treatment period (60 weeks) for rolled-over participants, Change in physical activity, Change in pain intensity, Change in HRQoL, Incidence, severity, seriousness, and relatedness of adverse events (AEs), Change in total score and domain scores, Target joints resolution

Source: https://euclinicaltrials.eu/ctis-public/view/2025-521858-42-00